EU clinical trial 2023-503880-40-00: A phase II clinical trial to evaluate the safety, efficacy, and pharmacokinetics of RBD1016 injection in participants with chronic hepatitis B
Protocol code: RBHB1203
Sponsor: Suzhou Ribo Life Science Co. Ltd. (Pharmaceutical company). Phase: Therapeutic exploratory (Phase II). Countries: Sweden (ended).
Therapeutic area(s): Diseases [C] - Virus Diseases [C02]
Gender: Female, Male. Age: 18-64 years, 65+ years. Enrolment: 24.
Status: Ended. Start date (EU): 2023-09-19. End date (EU): 2025-10-15. End date: 2025-10-16. Decision date: 2023-05-17. Results received: Yes. Last updated: 2025-06-11.

Condition(s): Chronic hepatitis B
Product: light yellow transparent clear solution, 1 ml per vial, containing 4 μg of vitamin B2 (for coloring purpose only, inactive at this concentration), with the same appearance as RBD1016 injection, for subcutaneous injection.

Primary endpoint: Primary safety endpoint: Number and percentage of participants with adverse events (AEs), serious adverse events (SAEs), and adverse events of special interest (AESI) up to follow-up (FU) Week 24., Primary efficacy endpoint: The maximum decline (log value) of HBsAg level from baseline up to FU Week 24.
Endpoint(s): 1) The proportion of participants with HBsAg decline ≥1 log10 IU/mL from baseline to FU Week 24;, 2) PK parameters for RBD1016 and its metabolites, including but not limited to maximum concentration (Cmax), time to maximum concentration (Tmax), area under curve (AUC0-t, AUC0-inf), elimination half-life (t1/2), terminal rate constant (λz), apparent volume of distribution (Vd/F), apparent clearance (CL/F), steady state concentration (Css) up to FU Week 12.

Source: https://euclinicaltrials.eu/ctis-public/view/2023-503880-40-00